EU clinical trial 2024-514531-18-00: Phase 1 Study of Revumenib in Combination with Intensive Chemotherapy in Participants with AML Harboring Alterations in KMT2A/MLL, NPM1, or NUP98 Genes
Protocol code: SNDX-5613-0708
Sponsor: Syndax Pharmaceuticals Inc. (Pharmaceutical company). Phase: Human Pharmacology (Phase I)- Other. Countries: Spain (ongoing, recruitment ended), Netherlands (ongoing, recruitment ended).
Therapeutic area(s): Diseases [C] - Neoplasms [C04]
Gender: Female, Male. Age: 18-64 years, 65+ years. Enrolment: 22.
Status: Ongoing, recruitment ended. Start date (EU): 2025-05-20. Decision date: 2025-02-03. Results received: No. Last updated: 2026-06-23.
Decision dates by country: NL: 2025-02-06, ES: 2025-02-03

Condition(s): Acute Myeloid Leukemias

Source: https://euclinicaltrials.eu/ctis-public/view/2024-514531-18-00